EU clinical trial 2025-522148-42-00: A PHASE 1/1B, OPEN-LABEL, MULTICENTER, FIRST-IN-HUMAN DOSE ESCALATION AND DOSE EXPANSION STUDY TO EVALUATE THE SAFETY, TOLERABILITY, PHARMACOKINETICS, PHARMACODYNAMICS, AND ANTI-TUMOR ACTIVITY OF VVD-159642 AS A SINGLE AGENT AND IN COMBINATION IN PARTICIPANTS WITH ADVANCED SOLID TUMORS
Protocol code: VVD-159642-01
Sponsor: Vividion Therapeutics Inc. (Pharmaceutical company). Phase: Human Pharmacology (Phase I)- First administration to humans. Countries: Spain (authorised, recruitment pending).
Therapeutic area(s): Diseases [C] - Neoplasms [C04]
Gender: Female, Male. Age: 18-64 years, 65+ years. Enrolment: 32.
Status: Authorised, recruitment pending. Decision date: 2025-09-26. Results received: No. Last updated: 2025-09-26.

Condition(s): Advanced Solid Tumours

Source: https://euclinicaltrials.eu/ctis-public/view/2025-522148-42-00